EU clinical trial 2023-509343-27-00: An open-label, non-randomized extension study to evaluate the long-term efficacy, safety and tolerability of LNP023 in subjects with C3 glomerulopathy or idiopathic immune-complex-membranoproliferative glomerulonephritis
Protocol code: CLNP023B12001B
Sponsor: Novartis Pharma AG (Pharmaceutical company). Phase: Phase III and phase IV (Integrated). Countries: Germany (ongoing, recruiting), France (ongoing, recruiting), Czechia (ongoing, recruiting), Netherlands (ongoing, recruiting), Greece (ongoing, recruiting), Italy (ongoing, recruiting), Spain (ongoing, recruiting).
Therapeutic area(s): Diseases [C] - Immune System Diseases [C20]
Gender: Female, Male. Age: 0-17 years, 18-64 years, 65+ years. Enrolment: 50.
Status: Ongoing, recruiting. Start date (EU): 2019-10-28. Decision date: 2024-08-21. Results received: No. Last updated: 2026-06-05.
Decision dates by country: CZ: 2024-08-22, NL: 2024-08-22, IT: 2024-09-24, FR: 2024-08-22, GR: 2024-08-22, ES: 2024-08-21, DE: 2024-08-22

Condition(s): C3 Glomerulopathy or idiopathic immune-complex membranoproliferative glomerulonephritis
Product: IPTACOPAN, IPTACOPAN HYDROCHLORIDE

Primary endpoint: Participants from study CLNP023X2202: • Composite renal endpoint met at the 9-month visit if following criteria satisfied: (1) stable or improved eGFR compared to the baseline visit in CLNP023X2202 (≤10% reduction in eGFR) and (2) either ≥50% reduction compared to the baseline visit in CLNP023X2202 or reduction to <300 mg/g in UPCR and (3) either a ≥50% increase in C3 compared to baseline or an increase to ≥90 mg/dL., Participants from study CLNP023X2202: • Change from baseline in the C3 Deposit Score (based on immunofluorescence microscopy) compared to baseline in the CLNP023X2202 study., Participants from study CLNP023X2202: • Occurrence of clinically significant vital signs (msDBP, msSBP, heart rate), ECGs, and safety laboratory measurements, as well as adverse events (AEs), AEs of special interest, and study drug discontinuation due to an AE (or any safety issue)., Participants from studies CLNP023B12301 or CLNP023B12302: • Occurrence of clinically significant vital signs (msDBP, msSBP, heart rate), ECGs, and safety laboratory measurements, as well as adverse events (AEs), AEs of special interest, and study drug discontinuation due to an AE (or any safety issue).
Endpoint(s): Participants from study CLNP023X2202: • Composite renal endpoint met at the 9-month visit if following criteria satisfied: (1) a stable or improved eGFR compared to the baseline visit in CLNP023X2202 (≤10% reduction in eGFR), and (2) either ≥50% reduction compared to the baseline visit in CLNP023X2202 or a reduction to <300 mg/g in UPCR., Participants from study CLNP023X2202: • Change from baseline in log-transformed urine protein/creatinine ratio (UPCR), change from baseline in log-transformed urine albumin/creatinine ratio (UACR), change from baseline in serum creatinine concentration and change from baseline in estimated glomerular filtration rate (eGFR) at the 9-month visit in CLNP023B12001B., Participants from study CLNP023X2202: • Change from baseline in log-transformed urine protein/creatinine ratio (UPCR) and change from baseline in log-transformed urine albumin/creatinine ratio (UACR), at the 3-month visit in CLNP023B12001B., Participants from study CLNP023X2202: • Disease activity and chronicity scores from a renal biopsy at 6 to 9 months from entry to the CLNP023B12001B study. Biopsies will be compared to those obtained in the CLNP023X2202 study (if available)., Participants from study CLNP023X2202: • Log-transformed ratio to baseline in serum C3 at the 9-month visit in CLNP023B12001B., Participants from study CLNP023X2202: • Composite renal endpoint met at times >9 months if following criteria satisfied: (1) stable or improved eGFR compared to the baseline visit in CLNP023X2202 (≤10% reduction in eGFR), (2) either ≥50% reduction compared to the baseline visit in CLNP023X2202 or a reduction to <300 mg/g in UPCR and (3) either a ≥50% increase in C3 compared to baseline or an increase to ≥90 mg/dL., Participants from study CLNP023X2202: • Change from baseline in log-transformed UPCR, log-transformed UACR, serum creatinine concentration and estimated glomerular filtration rate (eGFR) at times >9 months in CLNP023B12001B. Change in eGFR slope., Participants from study CLNP023X2202: • Log-transformed ratio to baseline in serum C3 at times >9 months in CLNP023B12001B., Participants from study CLNP023X2202: • Determine plasma iptacopan concentration up to 12 months at trough., Participants from studies CLNP023B12301 or CLNP023B12302: • Change from initiation of iptacopan treatment in the core study in log-transformed UPCR over time., Participants from studies CLNP023B12301 or CLNP023B12302: • Change from initiation of iptacopan treatment in the core study in eGFR over time., Participants from studies CLNP023B12301 or CLNP023B12302: • Composite renal endpoint met if following criteria satisfied (1) eGFR (a stable or improved eGFR, i.e., ≤15% reduction in eGFR compared to the initiation of iptacopan treatment in the core study) and (2) UPCR (≥50% reduction in UPCR compared to the initiation of iptacopan treatment in the core study).

Source: https://euclinicaltrials.eu/ctis-public/view/2023-509343-27-00